EU clinical trial 2024-517782-16-00: Randomized and multicentre Phase II study of FOLFOX6m + monoclonal Ab (anti-EGFR or bevacizumab) alone or in combination with hepatic chemoembolization (Lifepearls-Irinotecan) in patients with colorectal cancer and metastatic disease limited to the liver with bad prognosis.
Protocol code: GEMCAD-1802
Sponsor: Grupo Espanol Multidisciplinar En Cancer Digestivo (Hospital/Clinic/Other health care facility). Phase: Therapeutic exploratory (Phase II). Countries: Spain (ongoing, recruitment ended).
Therapeutic area(s): Diseases [C] - Neoplasms [C04]
Gender: Female, Male. Age: 18-64 years, 65+ years. Enrolment: 45.
Status: Ongoing, recruitment ended. Start date (EU): 2024-10-10. Decision date: 2024-10-10. Results received: No. Last updated: 2025-12-09.

Condition(s): Colorectal cancer and metastatic disease limited to the liver with bad prognosis.
Product: Avastin 25 mg/ml concentrate for solution for infusion., Vectibix 20 mg/ml concentrate for solution for infusion, Folinato Cálcico Hikma, 10 mg/ml solución inyectable y para perfusión EFG, Oxaliplatino Kabi 5 mg/ml concentrado para solución para perfusión EFG, Erbitux 5 mg/mL solution for infusion, Irinotecan Hydrochloride Trihydrate Fair-Med Healthcare 20 mg/ml concentrate for solution for infusion, Fluorouracilo Accord 50 mg/ml solución inyectable o para perfusión EFG

Primary endpoint: Proportion of patients who present an objective radiological response rate at 6 months of treatment. The objective response rate is understood to be the proportion of patients with reduction in tumor size according to RECIST 1.1 criteria.
Endpoint(s): Overall survival time. Overall survival is understood as the time elapsed from the inclusion of the patient in the study to the date of death from any cause., Progression-free survival time. PFS is understood as the time elapsed from the inclusion of the patient in the study to the date of radiological progression or death. Patients without radiological documentation of progression will be censored on the date of the last control without evidence of progression., Proportion of patients with clinical adverse events, laboratory abnormalities and proportion of patients with discontinuation of treatment due to toxicity or intolerance., Hepatic PFS: time from patient inclusion in the study to liver radiological progression according to RECIST 1.1 criteria., Proportion of patients undergoing R0 surgery for liver metastases.

Source: https://euclinicaltrials.eu/ctis-public/view/2024-517782-16-00